EU clinical trial 2025-523877-40-00: TREAT-EC (Tirzepatide in the treatment of endometrial cancer) - a clinical trial
Protocol code: CRC.0007
Sponsor: University College Dublin (Educational Institution). Phase: Therapeutic exploratory (Phase II). Countries: Ireland (authorised, recruitment pending).
Therapeutic area(s): Diseases [C] - Neoplasms [C04]
Gender: Female. Age: 18-64 years, 65+ years. Enrolment: 78.
Status: Authorised, recruitment pending. Decision date: 2026-04-02. Results received: No. Last updated: 2026-04-02.

Condition(s): Endometrial adenocarcinoma
Product: Mounjaro 2.5 mg/dose KwikPen solution for injection in pre-filled pen, Mirena 52 mg Intrauterine delivery system, Mounjaro 15 mg/dose KwikPen solution for injection in pre-filled pen, Mounjaro 5 mg/dose KwikPen solution for injection in pre-filled pen, Mounjaro 7.5 mg/dose KwikPen solution for injection in pre-filled pen, Mounjaro 10 mg/dose KwikPen solution for injection in pre-filled pen, Mounjaro 12.5 mg/dose KwikPen solution for injection in pre-filled pen

Primary endpoint: The proportion (%) of patients with a pCR in each group 12 months (52 weeks ±14 days) post randomisation. pCR will be defined as the absence of any EAC or endometrial hyperplasia on endometrial biopsy using a H&E slide assessed by an independent pathologist after 12 months (Visit 14, 52 weeks ±14 days) of treatment.
Endpoint(s): The mean percentage fasting weight loss at 12 months (Visit 14, 52 weeks ±14 days) post randomization., The change in Ki-67 PI 12 months (Visit 14, 52 weeks ±14 days) post randomization., Quality of life assessment at baseline (day -30 to 0), 3 (Visit 4, Week 12, 6 (Visit 7, Week 24), and 12 months (Visit 14, 52 weeks ±14 days)., Safety - The proportion of patients who develop progressive disease during the trial at 6 and 12 months. Progression is defined in section 3.4., Progression to surgery - The proportion of patients who progress to surgical management of endometrial cancer ie. hysterectomy following weight loss

Source: https://euclinicaltrials.eu/ctis-public/view/2025-523877-40-00